EU clinical trial 2025-523368-19-00: A study to investigate the pharmacokinetics and safety of KM04 compared to US-Gonal-f RFF Redi-ject and EU-Gonal-f in healthy adult female volunteers
Protocol code: KM04-101
Sponsor: Xentria Inc. (Pharmaceutical company). Phase: Human Pharmacology (Phase I)- Bioequivalence Study. Countries: Poland (not authorised).
Therapeutic area(s): Phenomena and Processes [G] - Reproductive and Urinary Physiological Phenomena [G08]
Gender: Female. Age: 18-64 years. Enrolment: 48.
Status: Not authorised. Decision date: 2026-03-23. Results received: No. Last updated: 2026-03-23.

Condition(s): Functional female infertility

Source: https://euclinicaltrials.eu/ctis-public/view/2025-523368-19-00